EU clinical trial 2024-513160-25-00: An open-label, multi-center, single arm, rollover study of GME751 (proposed pembrolizumab biosimilar) in participants who are eligible for continued pembrolizumab treatment after participation in CGME751A12101 or CGME751A12301 studies.
Protocol code: CGME751A12302
Sponsor: H e x a l AG (Pharmaceutical company). Phase: Therapeutic confirmatory (Phase III). Countries: Romania (ongoing, recruitment ended), Lithuania (ended), Spain (ongoing, recruitment ended).
Therapeutic area(s): Diseases [C] - Neoplasms [C04]
Gender: Female, Male. Age: 18-64 years, 65+ years. Enrolment: 81.
Start date (EU): 2024-10-30. Decision date: 2024-09-16. Results received: No. Last updated: 2026-08-03.
Decision dates by country: ES: 2025-04-10, LT: 2025-03-13, RO: 2024-09-16

Condition(s): Melanoma and Non-small-cell lung cancer
Product: pembrolizumab, Pemetrexed STADA® 25 mg/ml Konzentrat zur Herstellung einer Infusionslösung

Primary endpoint: Cohort A (Melanoma): SAEs up to 6 – 12 months (EOS/ED) after start of treatment in Study 302 Cohort B (NSCLC): SAEs up to 12- 24 months (EOS/ED) after start of treatment in Study 302

Source: https://euclinicaltrials.eu/ctis-public/view/2024-513160-25-00